EU clinical trial 2023-504719-34-00: A Phase 3, Randomized, Double-blind, Placebo-controlled, Parallel-group, Multicenter Study to Evaluate the Efficacy and Safety of Guselkumab Subcutaneous Induction Therapy in Participants with Moderately to Severely Active Ulcerative Colitis
Protocol code: CNTO1959UCO3004
Sponsor: Janssen - Cilag International (Pharmaceutical company). Phase: Therapeutic confirmatory (Phase III). Countries: Slovakia (ended), Czechia (ongoing, recruitment ended), Poland (ongoing, recruitment ended), Bulgaria (ongoing, recruitment ended), Belgium (ongoing, recruitment ended), France (ongoing, recruitment ended), Spain (ongoing, recruitment ended), Germany (ongoing, recruitment ended), Hungary (ongoing, recruitment ended).
Therapeutic area(s): Diseases [C] - Immune System Diseases [C20]
Gender: Female, Male. Age: 18-64 years, 65+ years. Enrolment: 143.
Start date (EU): 2023-02-21. Decision date: 2024-06-18. Results received: No. Last updated: 2026-06-05.
Decision dates by country: SK: 2024-06-18, CZ: 2024-06-20, BG: 2024-07-02, DE: 2024-07-08, ES: 2024-06-18, PL: 2024-07-10, BE: 2024-06-18, HU: 2024-06-18, FR: 2024-06-20

Condition(s): Moderate to Severly Active Ulcerative Colitis
Product: Guselkumab, Guselkumab - solution for injection in pre-filled syringe - 100 mg/mL, Guselkumab 2 mL PFS Placebo, Guselkumab 1 mL PFS Placebo

Primary endpoint: Clinical remission (at week 12)

Source: https://euclinicaltrials.eu/ctis-public/view/2023-504719-34-00